EU clinical trial 2025-522981-61-00: Inavolisib for PIK3CA mutated advanced endometrial cancer:a multicentric, phase II, MITO END-4 trial
Protocol code: MITO END-4
Sponsor: IRCCS Istituto Nazionale Tumori Fondazione Pascale (Hospital/Clinic/Other health care facility). Phase: Therapeutic exploratory (Phase II). Countries: Italy (ongoing, recruiting).
Therapeutic area(s): Diseases [C] - Female Urogenital Diseases and Pregnancy Complications [C13]
Gender: Female. Age: 18-64 years, 65+ years. Enrolment: 48.
Status: Ongoing, recruiting. Start date (EU): 2026-05-19. Decision date: 2026-02-12. Results received: No. Last updated: 2026-02-12.

Condition(s): endometrial cancer
Product: INAVOLISIB

Primary endpoint: Objective response rate (ORR) defined as a complete response (CR) or partial response (PR) by the Investigator using RECIST 1.1 criteria on the whole treatment period
Endpoint(s): Description of 6 months progression-free survival (PFS), Description of disease-control rate (DCR), Description of duration of response (DoR), Description of response rate in patients with different PIK3CA mutations, Description of response rate in patients with in patients with PIK3CA mutations and PTEN intact, Description of 1 year overall survival (OS), Description of response rate to inavolisib with respect to the PTEN molecular status including LOF in order to assess its potential predictive role of response, To evaluate the safety of inavolisib in endometrial cancer patients according to Common CTCAE version 5.0 in the overall study population., To evaluate the response to inavolisib in correlation with molecular characteristics of the tumour evaluated on the tissue samples and to follow the identified mutations in the blood during therapy through:-detection of associated mutations in paraffin embedded sample from the primary surgery/biopsy (chemotherapy - naive patients);-detection of tumor fraction and mutation in ctDNA

Source: https://euclinicaltrials.eu/ctis-public/view/2025-522981-61-00